EU clinical trial 2024-514473-21-00: Optimizing MATRix as remission induction in PCNSL: De-escalated induction treatment in newly diagnosed primary CNS lymphoma – a randomized phase III trial
Protocol code: SCC215/P002900
Sponsor: Klinikum Der Landeshauptstadt Stuttgart gKAöR (Hospital/Clinic/Other health care facility). Phase: Therapeutic confirmatory (Phase III). Countries: Austria (ongoing, recruitment ended), Italy (ongoing, recruitment ended), Germany (ongoing, recruitment ended).
Therapeutic area(s): Diseases [C] - Hemic and Lymphatic Diseases [C15]
Gender: Female, Male. Age: 18-64 years, 65+ years. Enrolment: 286.
Status: Ongoing, recruitment ended. Start date (EU): 2021-06-21. Decision date: 2024-11-07. Results received: No. Last updated: 2026-05-13.
Decision dates by country: IT: 2024-11-11, AT: 2024-11-08, DE: 2024-11-07

Condition(s): Primary diffuse large B-cell lymphoma (DLBCL) of the central nervous system is a rare disorder confined to the cerebral parenchyma, leptomeninges, eyes or spinal cord. It accounts for 4 to 6% of all Non- Hodgkin's lymphomas and for 3 to 4% of all primary brain tumors. Incidence of PCNSL has increased over the past 30 years, particularly in immunocompetent individuals. With a median survival of 3 months in untreated individuals, prognosis of PCNSL resembles that of systemic high-grade NHL
Product: RITUXIMAB, CYTARABINE, CARMUSTINE, BUSULFAN, METHOTREXATE DISODIUM, THIOTEPA

Primary endpoint: Event-free survival (EFS, defined as time from randomization to premature end of treatment due to any reason, lymphoma progression or death, whichever occurs first).
Endpoint(s): • Overall survival (OS) • Progression free survival (PFS) • Remission prior to consolidation therapy – RA II • Remission after consolidation – 30 days after ASCT (RA III) • Proportion of patients reaching consolidation • Quality of life (QoL): EORTC QLQ-C30, EORTC QLQ-BN20; measured during screening period, at EOT (30 days after ASCT) and thereafter every 12 months during follow-up.

Source: https://euclinicaltrials.eu/ctis-public/view/2024-514473-21-00